EU clinical trial 2024-518855-43-00: Effect of dapagliflozin on serum magnesium in HNF1ß patients with renal hypomagnesemia
Protocol code: 112930
Sponsor: Radboud universitair medisch centrum Stichting (Hospital/Clinic/Other health care facility). Phase: Therapeutic confirmatory (Phase III). Countries: Netherlands (ended).
Therapeutic area(s): Diseases [C] - Congenital, Hereditary, and Neonatal Diseases and Abnormalities [C16]
Gender: Female, Male. Age: 18-64 years, 65+ years. Enrolment: 12.
Status: Ended. End date (EU): 2025-05-01. Decision date: 2024-11-22. Results received: No. Last updated: 2024-11-22.

Condition(s): Hypomagnesemia due to HNF1beta mutation
Product: DAPAGLIFLOZIN, PLACEBO

Primary endpoint: Change in serum magnesium

Source: https://euclinicaltrials.eu/ctis-public/view/2024-518855-43-00